EU clinical trial 2024-514243-29-01: CAALL-F01: a French protocol for the treatment of acute lymphoblastic leukemia (ALL) in children and adolescents
Protocol code: P091205
Sponsor: Assistance Publique Hopitaux De Paris (Hospital/Clinic/Other health care facility). Phase: Therapeutic confirmatory (Phase III). Countries: France (authorised, recruitment pending).
Therapeutic area(s): Diseases [C] - Immune System Diseases [C20]
Gender: Female, Male. Age: 0-17 years. Enrolment: 1636.
Status: Authorised, recruitment pending. Decision date: 2024-10-10. Results received: No. Last updated: 2026-04-07.

Condition(s): This is a prospective, French, multicenter, open-label, design, stratified on the immunophenotypic characterization (B- or T- lineage) and the patient risk group, that aims at evaluating the efficacy and the tolerance of different schedules of pegaspargase in patients from 12 months to less than 18 years newly diagnosed with standard/medium-risk ALL
Product: PEGASPARGASE

Primary endpoint: o Adequate asparaginase activity (>100 IU/L) at D33 of induction o Toxicity: Incidence of severe toxicities (Grade ≥ 3) directly asparaginaserelated (CNS thrombosis, pancreatitis, anaphylaxia, and hyperbilirubinemia) between D12 and D49 of treatment and anyway before D8 of consolidation
Endpoint(s): - to evaluate the incidence of rare subgroups of ALL and their prognostic value e.g. so-called “B-other” subgroup: BCR-ABL like (including EBF1-PDGFRB), MEF2D-X, ZNF384-X, TCF3-HLF… - 5 year EFS, DFS and OS of the rare patients with suboptimal response to therapy (induction failure or MRDTP1 ≥ 10-3) and ABL-class fusions ALLs treated with imatinib - Imatinib related adverse events in the rare patients with suboptimal response to therapy (induction failure

Source: https://euclinicaltrials.eu/ctis-public/view/2024-514243-29-01